EU clinical trial 2023-509206-29-00: A Phase 3 Clinical Trial to Compare Efficacy, Safety, Tolerability and Immunogenicity of RBS-001 to Eylea® in Subjects with Neovascular Age-Related Macular Degeneration
Protocol code: PD-CP-Y1
Sponsor: Rophibio Inc. (Pharmaceutical company). Phase: Therapeutic confirmatory (Phase III). Countries: Bulgaria (ended), Croatia (ended), Slovakia (ended), Poland (ended).
Therapeutic area(s): Diseases [C] - Eye Diseases [C11]
Gender: Female, Male. Age: 18-64 years, 65+ years. Enrolment: 289.
Status: Ended. End date (EU): 2025-04-17. End date: 2025-04-18. Decision date: 2024-05-07. Results received: No. Last updated: 2025-02-24.
Decision dates by country: HR: 2024-05-09, PL: 2024-05-07, BG: 2024-05-13, SK: 2024-05-07

Condition(s): Neovascular age-related macular degeneration (nAMD)
Product: Eylea 40 mg/mL solution for injection in a vial, FLUORESCEIN SODIUM

Primary endpoint: Change from baseline (Day 1) in BCVA measured by ETDRS letter score at 8 weeks after the IP treatment
Endpoint(s): Change from baseline (Day 1) in BCVA measured by ETDRS letter score at all visits after the IP treatment will be analyzed using MMRM that includes the data from Weeks 4, 8, 12, 16, 20 and 24 after IP treatment, Change from baseline (Day 1) in BCVA measured by ETDRS letter score at each time point (within 52 weeks) after the IP treatment, Proportion of subjects whose BCVA measured by ETDRS letter score decreases by ≥ 5, ≥ 10 and ≥ 15 letters from baseline (Day 1) at all visits after the IP treatment, Proportion of subjects whose BCVA measured by ETDRS letter score increases by ≥5, ≥10 and ≥15 letters from baseline (Day 1) at all visits after the IP treatment, Change from baseline (Day 1) in CST measured by OCT at each time point (within 52 weeks) after the IP treatment, Proportion of subjects with intraretinal or subretinal fluid measured by OCT at each measurement time point after the IP treatment compared to baseline (Day 1), Change from screening in CNV area assessed by FA at 24 and 52 weeks after the IP treatment, Proportion of subjects having leakage assessed by FA at 24 and 52 weeks after the IP treatment compared to screening

Source: https://euclinicaltrials.eu/ctis-public/view/2023-509206-29-00